EU clinical trial 2025-525125-12-00: A Study to Compare the Blood Levels of Two Dosage Formulations of the Study Medicine in Healthy Adults
Protocol code: C4951092
Sponsor: Pfizer Inc. (Pharmaceutical company). Phase: Human Pharmacology (Phase I)- Bioequivalence Study. Countries: Belgium (ongoing, recruitment ended).
Therapeutic area(s): Diseases [C] - Nervous System Diseases [C10]
Gender: Female, Male. Age: 18-64 years, 65+ years. Enrolment: 36.
Status: Ongoing, recruitment ended. Start date (EU): 2026-05-05. Decision date: 2026-04-28. Results received: No. Last updated: 2026-08-03.

Condition(s): Migraine with or without aura

Source: https://euclinicaltrials.eu/ctis-public/view/2025-525125-12-00